EU clinical trial 2026-525752-29-00: A Phase I, open-label study in healthy adults comparing the availability in the body of the active substance lidocaine following administration of 2% and 4% lidocaine gel into the urethra
Protocol code: LIDEXU
Sponsor: Farco-Pharma GmbH (Pharmaceutical company). Phase: Human Pharmacology (Phase I)- Bioequivalence Study. Countries: Germany (ended).
Therapeutic area(s): Analytical, Diagnostic and Therapeutic Techniques and Equipment [E] - Anesthesia and Analgesia [E03]; Diseases [C] - Male Urogenital Diseases [C12]; Diseases [C] - Female Urogenital Diseases and Pregnancy Complications [C13]
Gender: Male. Age: 18-64 years. Enrolment: 28.
Status: Ended. Start date (EU): 2026-06-01. End date (EU): 2026-07-14. Decision date: 2026-05-05. Results received: No. Last updated: 2026-05-05.

Condition(s): bioavailability trial with healthy participants, therapeutic indication not studied

Source: https://euclinicaltrials.eu/ctis-public/view/2026-525752-29-00